EU clinical trial 2023-504914-31-00: Lowering of LDL-C with rosuvastatin or single-pill combination rosuvastatin/ezetimibe in high/very high-risk patients with hyperlipidaemia – LEASH
Protocol code: KCT10/2022-LEASH
Sponsor: KRKA tovarna zdravil d.d. Novo mesto (Pharmaceutical company). Phase: Phase III and phase IV (Integrated). Countries: Slovenia (ended), Poland (ended), Germany (ended), Hungary (ended), Croatia (ended).
Therapeutic area(s): Diseases [C] - Cardiovascular Diseases [C14]
Gender: Female, Male. Age: 18-64 years, 65+ years. Enrolment: 195.
Status: Ended. Start date (EU): 2024-11-10. End date (EU): 2026-01-07. End date: 2026-01-08. Decision date: 2024-06-03. Results received: No. Last updated: 2025-11-07.
Decision dates by country: SI: 2024-06-03, PL: 2024-06-10, DE: 2024-06-06, HU: 2024-06-10, HR: 2024-06-05

Condition(s): Hyperlipidaemia
Product: Sorvasta 20 mg filmsko obložene tablete, Sorvitimb 20 mg/10 mg filmsko obložene tablete, Sorvasta 10 mg filmsko obložene tablete, Sorvasta 40 mg filmsko obložene tablete, Sorvitimb 40 mg/10 mg filmsko obložene tablete

Primary endpoint: Proportion of patients achieving the LDL-C treatment goal* after 12 weeks of treatment (from baseline to Visit 5) in ARM 1 and ARM 2 separately. ______________________ *Patients at very high cardiovascular (CVD) risk: LDL-C reduction of ≥50 % from baseline AND LDL-C <1.4 mmol/L (<55 mg/dL); patients at high CVD risk: LDL-C reduction of ≥50 % from baseline AND LDL-C <1.8mmol/L (<70 mg/dL).
Endpoint(s): Proportion of patients achieving LDL-C treatment goal*, after 4 and 8 weeks of treatment (from baseline to Visit 3 and to Visit 4) in ARM 1 and ARM 2 separately. ______________________ *Patients at very high cardiovascular (CVD) risk: LDL-C reduction of ≥50 % from baseline AND LDL-C <1.4 mmol/L (<55 mg/dL); patients at high CVD risk: LDL-C reduction of ≥50 % from baseline AND LDL-C <1.8mmol/L (<70 mg/dL)., Proportion of patients achieving LDL-C reduction ≥50 % from baseline, after 4, 8 or 12 weeks of treatment (from baseline to Visit 3, to Visit 4 and to Visit 5) in ARM 1 and ARM 2 separately., Proportion of patients achieving LDL-C target values** after 4, 8 and 12 weeks of treatment (at Visit 3, Visit 4 and Visit 5, respectively) in ARM 1 and ARM 2 separately. _______________________ **LDL-C target value for patients at very high cardiovascular (CVD) risk: LDL-C <1.4mmol/L (<55 mg/dL); LDL-C target value patients at high CVD risk: <1.8mmol/L (<70 mg/dL)., Proportion of patients achieving target& non-HDL-C, after 4, 8 and 12 weeks of treatment (at Visit 3, Visit 4 and Visit 5) in ARM 1 and ARM 2 separately. _______________________ &Non-HDL-C target for patients at very high CVD risk: <2.2mmol/L (<85 mg/dL); non-HDL-C target for patients at high CVD risk: <2.6mmol/L (<100 mg/dL)., Mean absolute and relative changes in TC, LDL-C, non-HDL-C, HDL-C, and TG, after 4, 8 and 12 weeks of treatment (from baseline to Visit 3, to Visit 4 and to Visit 5) in ARM 1 and ARM 2 separately., Proportion of compliant# patients after 4, 8 and 12 weeks (at Visit 3, Visit 4 and Visit 5, respectively) of treatment in ARM 1 and ARM 2 separately. ________________________ #Patients are considered compliant to treatment, if ≥80 % of their prescribed doses were administered. One dose omission is defined as omission of 1 tablet of rosuvastatin or SPC rosuvastatin/ezetimibe per day in ARM 1 OR omission of 1 tablet of rosuvastatin or SPC rosuvastatin/ezetimibe per day in ARM 2., Proportion of patients achieving LDL-C treatment goal* after 4, 8 and 12 weeks of treatment in ARM1 in comparison with ARM2. ______________________ *Patients at very high cardiovascular (CVD) risk: LDL-C reduction of ≥50 % from baseline AND LDL-C <1.4 mmol/L (<55 mg/dL); patients at high CVD risk: LDL-C reduction of ≥50 % from baseline AND LDL-C <1.8mmol/L (<70 mg/dL).

Source: https://euclinicaltrials.eu/ctis-public/view/2023-504914-31-00